EU clinical trial 2024-518026-32-00: Atezolizumab, Pertuzumab and Trastuzumab with chemotherapy as neoadjuvant treatment of HER2 positive early high-risk and locally advanced breast cancer (APTneo)
Protocol code: FM-17-B01
Sponsor: Fondazione Michelangelo (Pharmaceutical company). Phase: Therapeutic confirmatory (Phase III). Countries: Spain (authorised, recruitment pending), Germany (authorised, recruitment pending), Italy (authorised, recruitment pending), Austria (authorised, recruitment pending), Belgium (authorised, recruitment pending), Romania (authorised, recruitment pending).
Therapeutic area(s): Diseases [C] - Neoplasms [C04]
Gender: Female. Age: 18-64 years, 65+ years. Enrolment: 646.
Status: Authorised, recruitment pending. Decision date: 2024-11-21. Results received: No. Last updated: 2026-07-10.
Decision dates by country: AT: 2024-11-25, RO: 2024-11-27, DE: 2024-11-22, IT: 2024-11-25, BE: 2024-11-25, ES: 2024-11-21

Condition(s): Invasive Breast Cancer
Product: Phesgo 600 mg/600 mg solution for injection, Kadcyla 160 mg powder for concentrate for solution for infusion., Tecentriq 1 200 mg concentrate for solution for infusion, Perjeta 420 mg concentrate for solution for infusion, Phesgo 1200 mg/600 mg solution for injection

Primary endpoint: Event Free Survival (EFS)
Endpoint(s): Pathological Complete Response (pCR), Relationship between pCR and EFS, Clinical Overall Response (cOR) at the end of neo-adjuvant treatment, Disease-Free Survival (DFS), Distant Event Free Survival, Overall Survival

Source: https://euclinicaltrials.eu/ctis-public/view/2024-518026-32-00